EU clinical trial 2025-523009-14-00: A Phase IIb Randomized, Double-blind, Placebo-controlled, Parallel, Multidose Study to Evaluate the Efficacy, Safety, and PK of AZD0292 in Participants 12 years of Age and Older With Bronchiectasis and Chronic Pseudomonas aeruginosa Colonization
Protocol code: D7700C00003
Sponsor: AstraZeneca AB (Pharmaceutical company). Phase: Therapeutic exploratory (Phase II). Countries: Netherlands (ongoing, recruiting), Italy (ongoing, recruiting), Greece (ongoing, recruiting), Denmark (ongoing, recruiting), Belgium (ongoing, recruiting), Spain (ongoing, recruiting), France (ongoing, recruiting), Germany (ongoing, recruiting).
Therapeutic area(s): Diseases [C] - Respiratory Tract Diseases [C08]
Gender: Female, Male. Age: 18-64 years, 65+ years. Enrolment: 112.
Status: Ongoing, recruiting. Start date (EU): 2025-12-16. Decision date: 2025-10-31. Results received: No. Last updated: 2026-05-27.
Decision dates by country: IT: 2025-11-04, BE: 2025-11-03, GR: 2025-11-13, ES: 2025-11-04, DK: 2025-11-03, FR: 2025-11-14, NL: 2025-11-05, DE: 2025-11-03

Condition(s): Bronchiectasis with chronic pseudomonas aeruginosa colonization
Product: Placebo for AZD0292, AZD0292

Primary endpoint: Annualized rate of exacerbations over a variable follow-up time
Endpoint(s): Annualized rate of severe exacerbations over a variable follow-up time, Change from baseline in QoL-B-RSS, Change from baseline in SGRQ score, Time to first moderate or severe exacerbation and Time to first severe exacerbation, Serum PK concentrations of AZD0292 at all collected timepoints, Incidence of ADA to AZD0292 and ADA titers of AZD0292 at all collected timepoints, Occurrence of AEs collected from the first dose through 12 weeks after last IMP administration and SAEs, AESIs, and MAAEs, collected throughout the study

Source: https://euclinicaltrials.eu/ctis-public/view/2025-523009-14-00